EU clinical trial 2022-501426-38-00: J3L-MC-EZEB: A Phase 2, Randomized, Double-Blind, Placebo-Controlled Study to Investigate the Efficacy and Safety of LY3819469 in Adults with Elevated Lipoprotein(a)
Protocol code: 18547
Sponsor: Eli Lilly & Co. (Pharmaceutical company). Phase: Therapeutic exploratory (Phase II). Countries: Denmark (ended), Spain (ended), Netherlands (ended), Romania (ended), Germany (ended).
Therapeutic area(s): Diseases [C] - Nutritional and Metabolic Diseases [C18]
Gender: Female, Male. Age: 18-64 years, 65+ years. Enrolment: 125.
Status: Ended. Start date (EU): 2023-02-09. End date (EU): 2024-10-04. End date: 2024-10-17. Decision date: 2023-01-24. Results received: Yes. Last updated: 2024-09-02.
Decision dates by country: DK: 2023-01-24, RO: 2023-01-30, ES: 2023-01-26, NL: 2023-01-27, DE: 2023-01-30

Condition(s): Lipoprotein Disorder
Product: Placebo to match LY3819469

Primary endpoint: Percent change from baseline in time-averaged Lp(a) over Days 60-180

Source: https://euclinicaltrials.eu/ctis-public/view/2022-501426-38-00